EU clinical trial 2025-524058-32-00: A Phase 2a, Randomized, Participant- and Investigator blinded, Parallel-group, Placebo-controlled, Multicenter Study to Assess the Safety, Tolerability, and Treatment Response of GXV813 in Hospitalized Adults with DSM-5 Schizophrenia (STAR-1)
Protocol code: CGXV813B12201
Sponsor: Novartis Pharma AG (Pharmaceutical company). Phase: Therapeutic exploratory (Phase II). Countries: Bulgaria (ongoing, recruiting).
Therapeutic area(s): Psychiatry and Psychology [F] - Mental Disorders [F03]
Gender: Female, Male. Age: 18-64 years. Enrolment: 42.
Status: Ongoing, recruiting. Start date (EU): 2026-06-22. Decision date: 2026-04-29. Results received: No. Last updated: 2026-04-29.

Condition(s): Schizophrenia
Product: GXV813, GXV813, Placebo 0 mg Hard gelatin capsule

Primary endpoint: Change from baseline in PANSS (Positive and Negative Symptom Scale) total score at 6 weeks
Endpoint(s): Occurrence and severity of AEs, clinical laboratory tests, vital signs, ECG findings, physical examination, Modified Simpson-Angus Scale (mSAS), Barnes Akathisia Rating Scale (BARS), Abnormal Involuntary Movement Scale (AIMS) and suicidality assessment (Columbia Suicide Severity Rating Scale C-SSRS), Participant response; response is defined as clinically significant reduction in total PANSS (≥30% improvement in PANSS total score),OR a 1-point difference CGI-S-score at week 6., Change from baseline in PANSS positive subscore at week 6, Change from baseline in PANSS negative subscore and Marder negative factor score at week 6, Change from baseline in Clinical Global Impression‒Severity (CGI-S) scale at week 6, PK parameters such as but not limited to area under the plasma concentration-time curve (AUC), maximum observed plasma concentration (Cmax)

Source: https://euclinicaltrials.eu/ctis-public/view/2025-524058-32-00